EU clinical trial 2023-510515-19-00: Prospective randomized study on the feasibility of allogeneic stem cell transplantation in higher-risk-myelodysplastic syndromes, performed upfront or preceded by azacitidine or conventional chemotherapy, according to the BM-blast proportion (ACROBAT trial). MDS0519
Protocol code: MDS0519
Sponsor: Fondazione Gimema Franco Mandelli Onlus (Patient organisation/association). Phase: Therapeutic confirmatory (Phase III). Countries: Italy (ongoing, recruiting).
Therapeutic area(s): Diseases [C] - Hemic and Lymphatic Diseases [C15]
Gender: Female, Male. Age: 18-64 years, 65+ years. Enrolment: 274.
Status: Ongoing, recruiting. Start date (EU): 2020-11-27. Decision date: 2024-07-30. Results received: No. Last updated: 2026-08-03.

Condition(s): Higher-risk-myelodysplastic syndromes
Product: THIOTEPA, DAUNORUBICIN HYDROCHLORIDE, CYTARABINE, BUSULFAN, Azacitidine Accord 25 mg/mL powder for suspension for injection, FLUDARABINE PHOSPHATE

Primary endpoint: Feasibility of HSCT- Non-inferiority design. The feasibility of HSCT will be estimated in terms of proportion of patients who receive HSCT of the total number of randomized patients. For the primary endpoint of feasibility of HSCT, all patients who perform HSCT will be considered as "successes", and all others, as "failures". For the primary efficacy endpoint, sensitivity analyses will be performed adjusting the treatment comparison by factors which appeared to be of prognotic importance
Endpoint(s): Overall survival ITT, Event-free survival ITT (including relapse, progression, or death from any cause), Safety in terms of AE/SAEs, Pattern of relapse/progression after HSCT, Translational studies with mutational, and cytofluorimetric analysis (patient BMsampling at enrollment, before HSCT and at 6 months after HSCT), Quality of life assessment at enrollment, before HSCT and at 6 months after HSCT, Pharmacoeconomic evaluation (i.e. duration of hospitalization, RBC transfusions, etc)

Source: https://euclinicaltrials.eu/ctis-public/view/2023-510515-19-00